EU clinical trial 2023-506604-18-00: Study of PF-08046054/SGN-PDL1V in Advanced Solid Tumors
Protocol code: SGNPDL1V-00
Sponsor: Seagen Inc. (Pharmaceutical company). Phase: Human Pharmacology (Phase I)- First administration to humans. Countries: Italy (ongoing, recruiting), Netherlands (ongoing, recruiting), France (ongoing, recruiting), Belgium (ongoing, recruiting), Germany (ongoing, recruiting), Spain (ongoing, recruiting).
Therapeutic area(s): Diseases [C] - Neoplasms [C04]
Gender: Female, Male. Age: 18-64 years, 65+ years. Enrolment: 192.
Status: Ongoing, recruiting. Start date (EU): 2024-02-14. Decision date: 2023-10-06. Results received: No. Last updated: 2026-06-05.
Decision dates by country: FR: 2023-10-16, DE: 2023-10-06, ES: 2023-10-09, NL: 2023-10-09, BE: 2023-10-10, IT: 2023-10-20

Condition(s): Triple negative breast cancer, Squamous cell carcinoma of head and neck, Non-small cell lung cancer, Gastric cancer, Endometrial Cancer, Hepatocellular Carcinoma, Oesophageal squamous cell carcinoma, Pancreatic Adenocarcinoma, Head and neck squamous cell carcinoma

Source: https://euclinicaltrials.eu/ctis-public/view/2023-506604-18-00